EU clinical trial 2022-502161-19-00: A global, multicenter, randomized, double-blind, double-dummy, parallel-group, Phase 3b study to assess the efficacy, safety, and tolerability of remibrutinib 25 mg b.i.d. in comparison to placebo with omalizumab 300 mg every 4 weeks as active control over 52 weeks in adult patients with chronic spontaneous urticaria inadequately controlled by second-generation H1-antihistamines and an open-label 52-week optional extension to assess long-term efficacy, safety and tolerability of remibrutinib 25 mg b.i.d.
Protocol code: CLOU064A2304
Sponsor: Novartis Pharma AG (Pharmaceutical company). Phase: Therapeutic confirmatory (Phase III). Countries: Netherlands (ongoing, recruitment ended), France (ongoing, recruitment ended), Spain (ongoing, recruitment ended), Poland (ongoing, recruitment ended), Germany (ongoing, recruitment ended), Slovakia (ongoing, recruitment ended), Czechia (ongoing, recruitment ended), Hungary (ended), Bulgaria (ongoing, recruitment ended), Italy (ongoing, recruitment ended).
Therapeutic area(s): Diseases [C] - Skin and Connective Tissue Diseases [C17]
Gender: Female, Male. Age: 18-64 years, 65+ years. Enrolment: 218.
Start date (EU): 2024-03-12. Decision date: 2024-02-12. Results received: No. Last updated: 2026-07-07.
Decision dates by country: IT: 2024-02-13, PL: 2024-02-16, HU: 2024-02-12, FR: 2024-02-13, ES: 2024-02-12, CZ: 2024-02-13, NL: 2024-02-13, BG: 2024-02-19, SK: 2024-02-13, DE: 2024-02-14

Condition(s): Chronic Spontaneous Urticaria
Product: OMALIZUMAB, Placebo to Remibrutinib (LOU064) 25 mg film-coated tablet, Placebo to Xolair® (Omalizumab) 150 mg/ml solution for injection in pre-filled syringe, LOU064, Placebo to AIN457 150 mg/ 1 mL Solution for injection in pre-filled syringe. This placebo is an additional/ alternative placebo to placebo to Xolair® (Omalizumab) to ensure continuous supply in the clinical trial. For more details please refer to Note to Assessor located in the “Placebo to AIN457” product shell.

Primary endpoint: Absolute change from baseline in UAS7, ISS7 and HSS7 at Week 12
Endpoint(s): Achievement of UAS7=0 (yes/no) at Week 12, Improvement of severity of itch, assessed as absolute change from baseline in ISS7 score at Week 12, Improvement of severity of hives, assessed as absolute change from baseline in HSS7 score at Week 12, Absolute change from baseline in UAS7 at Week 12, Occurrence of treatment-emergent adverse events and serious adverse events (SAEs) during the study

Source: https://euclinicaltrials.eu/ctis-public/view/2022-502161-19-00